EU clinical trial 2026-526142-27-01: Tranexamic Acid in Hind and Midfoot Arthrodesis Surgery: A Multicentre, Randomized, Placebo-Controlled Trial (TRASH Trial)
Sponsor: HUS-yhtymae (Hospital/Clinic/Other health care facility). Phase: Therapeutic confirmatory (Phase III). Countries: Finland (authorised, recruitment pending).
Therapeutic area(s): Analytical, Diagnostic and Therapeutic Techniques and Equipment [E] - Therapeutics [E02]; Diseases [C] - Musculoskeletal Diseases [C05]
Gender: Female, Male. Age: 18-64 years, 65+ years. Enrolment: 450.
Status: Authorised, recruitment pending. Decision date: 2026-05-29. Results received: No. Last updated: 2026-05-29.

Condition(s): Deformity, Osteoarthritis
Product: Sodium Chloride Intravenous Infusion BP 0.9% w/v Solution for Infusion., Tranexamic acid Baxter 100 mg/ml injektio-/infuusioneste, liuos

Primary endpoint: Primary endpoint is a composite measure that combines superficial and deep SSIs up to one year. We will use the Centers for Disease Control and Prevention (CDC) definitions for SSI and categorise the infections as either superficial or deep.
Endpoint(s): Wound dehiscence is defined as either partial or total separation of the edges of previously approximated surgical wound with no signs of infection. The wound is assessed on at 2 weeks, 3 months and 12 months by a specialised nurse or a surgeon., Perioperative blood loss will be estimad by measuring haemoglobin levels on the day of surgery, both pre- and postoperatively, and reporting the absolute change in haemoglobin concentration (g/L)., Cumulative revision surgery rate for any reason is reported up to 12 month follow-up. This includes any revision surgery performed in the operating room at the site of the initial surgery site., Fusion rate will be evaluated at the 12-month follow-up visit using a computed tomography scan. Arthrodesis will be considered fused if osseous bridging is observed as determined by the assessing radiologist., Exploratory endpoints will be collected and analysed, but the results will be evaluated separately: The Manchester–Oxford foot questionnaire (MOxFQ), Patient Acceptable Symptom State (PASS), Pain Numerical Rating Scale, Cost Effectiveness

Source: https://euclinicaltrials.eu/ctis-public/view/2026-526142-27-01